EU clinical trial 2024-512112-22-01: Evaluation of the efficacy of Sphenopalatine Ganglion Block compared to Scalp Block in Supratentorial Intracranial Surgery : a Non-inferiority, Randomized, Controlled, Double-Blind Trial
Sponsor: Centre hospitalier universitaire de Liege (Hospital/Clinic/Other health care facility). Phase: Therapeutic use (Phase IV). Countries: Belgium (ongoing, recruiting).
Therapeutic area(s): Analytical, Diagnostic and Therapeutic Techniques and Equipment [E] - Anesthesia and Analgesia [E03]
Gender: Female, Male. Age: 18-64 years, 65+ years. Enrolment: 88.
Status: Ongoing, recruiting. Start date (EU): 2024-12-04. Decision date: 2024-09-06. Results received: No. Last updated: 2024-09-06.

Condition(s): Patients undergoing craniotomy for supratentorial mass
Product: MORPHINE HCl STEROP 10mg/1ml Solution injectable, Solu-Medrol S.A.B. (= Sine Alcohol Benzylicus) Act-O-Vial 125 mg Poudre et solvant pour solution injectable (méthylprednisolone), Chlorure de sodium 0,9% Fresenius Kabi solvant pour préparation parentérale, Propofol B. Braun 2 % (20 mg/ml), émulsion injectable ou pour perfusion, Levobupivacaïne Fresenius Kabi 5 mg/ml, solution injectable/ pour perfusion, Linisol 1 %, solution injectable, Ultiva 5 mg poudre pour solution à diluer pour solution injectable/pour perfusion, Paracetamol Fresenius Kabi 10 mg/ml solution pour perfusion, Etoricoxib AB 60 mg filmomhulde tabletten, Nimbex 2 mg/ml, solution injectable/pour perfusion

Primary endpoint: hemodynamic change observed at the time of placement of the spiked headrest (Mayfield's headrest).
Endpoint(s): Hemodynamic variation during skin incision, flap and dura mater incision, Analysis of intraoperative parameters (heart rate, blood pressure, Response and State Entropy (RE/SE), Surgical Plethysmographic Index (SPI) at the time of block, incision, craniectomy and dura mater incision., Absence of complications related to the block (AL toxicity, infection, etc.), Level of sleepiness in USPA (RASS score), Pain scores at the different time intervals shown in the table from the PCU to hospital discharge, Morphine use in the PACU and in the hospital ward, Length of hospital stay, Evaluation of QoR15 on D-1, D+1, D+3, D+7, Evaluation of patient satisfaction via the EVAN-G score, Presence of PONV, constipation, pruritus during hospitalization

Source: https://euclinicaltrials.eu/ctis-public/view/2024-512112-22-01